EU clinical trial 2024-515243-37-00: Intravenous Immunoglobulins for Prevention of BKV Viremia in Kidney Transplant Recipients According to BKV genotype-specific Neutralizing Antibody Titers at the day of transplantation: A Multicenter Study -BKANIG
Protocol code: 6997
Sponsor: Les Hopitaux Universitaires De Strasbourg (Hospital/Clinic/Other health care facility). Phase: Phase III and phase IV (Integrated). Countries: France (ongoing, recruiting).
Therapeutic area(s): Diseases [C] - Bacterial Infections and Mycoses [C01]
Gender: Female, Male. Age: 18-64 years, 65+ years. Enrolment: 664.
Status: Ongoing, recruiting. Start date (EU): 2022-08-21. Decision date: 2024-07-12. Results received: No. Last updated: 2024-07-12.

Condition(s): Kidney Transplantation BKV infection
Product: Privigen 100 mg/ml solution for infusion

Primary endpoint: The primary endpoint is the incidence of BKV viremia (> 3 log10 copies/mL ) 6 months after transplantation.
Endpoint(s): BKV NAb titers at the day (D) of transplantation (D0), and D10 ,D31, D52, M3, M6 and M12, Incidence of BKV viruria at D10, D31, D52, M3, M6 and M12, Incidence of BKV viremia > 3 log10 copies/mL in at least two, Incidence of TTV viremia at D0, D10, D31, D52, M3, M6 and M12, Evolution of T and B-cell repertoire against BKV at D0, M3, M6 and M12, Incidence of BKV nephropathy at M3, M6, and M12, Time of occurrence and duration of viruria, viremia and BKVAN, Genotype of replicative BKV, The predictive value of BKV Nab titers pre-transplantation for BKV replication after transplantation, GFR evaluated by CKD EPI formula at M3, M6 and M12, Percentage of patients with donor specific antibodies (DSA) at M3 and M12, Incidence of biopsy proved antibody mediated rejection at M3 and M12 according to Banff classification, Incidence of biopsy proved acute cellular rejection at M3 and M12 according to Banff classification, Patient and graft survival at M12, Tolerance of IVIG, adverse and severe adverse effects

Source: https://euclinicaltrials.eu/ctis-public/view/2024-515243-37-00